EU clinical trial 2023-508950-24-00: An Open-Label, Multicenter, Extension Study for Patients Previously Enrolled in Studies With Pelabresib
Protocol code: CDAK539A12001B
Sponsor: Novartis Pharma AG (Pharmaceutical company). Phase: Therapeutic confirmatory (Phase III). Countries: Belgium (ongoing, recruiting), Netherlands (ongoing, recruiting), Italy (ongoing, recruiting).
Therapeutic area(s): Diseases [C] - Neoplasms [C04]
Gender: Female, Male. Age: 18-64 years, 65+ years. Enrolment: 34.
Status: Ongoing, recruiting. Start date (EU): 2024-10-01. Decision date: 2024-08-29. Results received: No. Last updated: 2026-01-28.
Decision dates by country: BE: 2024-08-29, NL: 2024-08-29, IT: 2024-08-30

Condition(s): Myelofibrosis, Myeloproliferative Neoplasms (Myelofibrosis and Essential Thrombocythemia)
Product: CPI-0610, CPI-0610

Primary endpoint: Occurrence and severity of treatment-emergent adverse events (TEAEs) and serious TEAEs among patients who are receiving pelabresib, Survival and leukemia-free survival, Time-to-event endpoints (eg, duration of response, progression-free survival)

Source: https://euclinicaltrials.eu/ctis-public/view/2023-508950-24-00